EU clinical trial 2025-523486-17-00: A Phase 3, Randomized, Double-Blind, Placebo-Controlled Study to Evaluate the Efficacy and Safety of KAI-9531 Administered Once Weekly in Participants Living with Obesity or Overweight with Weight-Related Comorbidities Who Do Not Have Diabetes
Protocol code: K9531-3103
Sponsor: Kailera Therapeutics Inc. (Pharmaceutical company). Phase: Therapeutic confirmatory (Phase III). Countries: Bulgaria (ongoing, recruiting), Hungary (ended), Spain (ongoing, recruiting), Germany (ongoing, recruiting), Czechia (ongoing, recruiting), Poland (ongoing, recruiting).
Therapeutic area(s): Diseases [C] - Nutritional and Metabolic Diseases [C18]
Gender: Female, Male. Age: 18-64 years, 65+ years. Enrolment: 612.
Start date (EU): 2026-06-16. Decision date: 2026-05-05. Results received: No. Last updated: 2026-05-18.
Decision dates by country: BG: 2026-05-18, CZ: 2026-05-07, DE: 2026-05-05, HU: 2026-05-15, ES: 2026-05-07, PL: 2026-05-11

Condition(s): Obesity
Product: KAI-9531, KAI-9531, Identical to kai-9531 solution for injection without active drug, KAI-9531

Primary endpoint: Percent change in body weight (kg) from baseline at Week 76
Endpoint(s): Percent change in body weight (kg) from baseline at Week 76, From baseline at Week 76 Percentage of participants with ≥5%,≥10%, ≥15%, ≥20%, and ≥25% reduction in body weight (kg) Change in waist circumference (cm) Change in absolute body weight (kg) Change (all KAI-9531 doses combined) in SBP (mm Hg) Percent change (all KAI-9531 doses combined) in (fasting): − Triglycerides (mg/dL) − HDL-cholesterol (mg/dL) − Non-HDL-cholesterol (mg/dL) Change (all KAI-9531 doses combined) in IWQOL-Lite-CT physical function composite score, Percent change in body weight (kg) from baseline at Week 76 in the subgroup of participants with BMI ≥35 kg/m2, From baseline at Week 76:Percentage of participants with ≥30% reduction in body weight(kg).Change in BMI(kg/m2).Change(all KAI-9531 doses combined) in DBP (mm Hg).Percent change(all KAI-9531 doses combined) in(fasting):−Total cholesterol(mg/dL)−LDL-cholesterol(mg/dL)−VLDL-cholesterol(mg/dL). Percent change(all KAI-9531 doses combined) in fasting insulin (mIU/L).Change(all KAI-9531 doses combined) in fasting blood glucose (mg/dL).Change(all KAI-9531 doses combined) in COEQ, TEAEs, clinical laboratory parameters, ECGs, and vital sign, ADA NAb, Population PK Efficacy, safety, and tolerability exposure-response analysis

Source: https://euclinicaltrials.eu/ctis-public/view/2025-523486-17-00